EU clinical trial 2023-508747-49-00: RANDOMISED, CROSSOVER, SIMPLE-BLINDED, BIOEQUIVALENCE CLINICAL TRIAL OF ALMOTRIPTAN 12.5 MG ORODISPERSIBLE TABLETS VERSUS ALMOTRIPTAN 12.5 MG FILM-COATED TABLETS, AFTER A SINGLE ORAL DOSE ADMINISTRATION TO HEALTHY VOLUNTEERS UNDER FASTING
Protocol code: UECHUP-ALM/23-6
Sponsor: Qualix Pharma S.L. (Pharmaceutical company). Phase: Human Pharmacology (Phase I)- Bioequivalence Study. Countries: Spain (ended).
Therapeutic area(s): Diseases [C] - Nervous System Diseases [C10]
Gender: Female, Male. Age: 18-64 years. Enrolment: 28.
Status: Ended. Start date (EU): 2024-04-10. End date (EU): 2024-05-07. Decision date: 2024-04-05. Results received: No. Last updated: 2024-04-05.

Condition(s): Antimigraine

Source: https://euclinicaltrials.eu/ctis-public/view/2023-508747-49-00